EU clinical trial 2024-514713-35-00: A Phase I, open-label, fixed sequence drug interaction study in healthy subjects to investigate the effect of a 40 mg deucrictibant tablet administered once daily on the pharmacokinetics of the P-gp substrate digoxin and the BCRP substrate rosuvastatin, administered as a drug cocktail
Protocol code: PHA022121-C017
Sponsor: Pharvaris Netherlands B.V. (Pharmaceutical company). Phase: Human Pharmacology (Phase I)- Other. Countries: Netherlands (ended).
Therapeutic area(s): Diseases [C] - Congenital, Hereditary, and Neonatal Diseases and Abnormalities [C16]
Gender: Female, Male. Age: 18-64 years. Enrolment: 14.
Status: Ended. Start date (EU): 2024-08-08. End date (EU): 2024-10-21. Decision date: 2024-07-29. Results received: No. Last updated: 2024-07-29.

Condition(s): Hereditary angioedema

Source: https://euclinicaltrials.eu/ctis-public/view/2024-514713-35-00